EU clinical trial 2024-512347-23-00: A multicenter, open-label, controlled study to investigate the effect of either LF111 or Drospirenone chewable tablets on bone mineral density (BMD) in adolescent and adult women in comparison with non-users of hormonal contraceptive methods
Protocol code: LF111/401
Sponsor: Chemo Research S.L. (Pharmaceutical company). Phase: Therapeutic use (Phase IV). Countries: Poland (ongoing, recruitment ended), Czechia (ended).
Therapeutic area(s): Phenomena and Processes [G] - Musculoskeletal and Neural Physiological Phenomena [G11]
Gender: Female. Age: 0-17 years, 18-64 years. Enrolment: 940.
Start date (EU): 2022-08-22. Decision date: 2024-06-05. Results received: No. Last updated: 2026-07-24.
Decision dates by country: CZ: 2024-06-05, PL: 2024-06-10

Condition(s): Oral contraception
Product: Placebo (green tablets: inactive ingredients: lactose, maize starch, povidone, silica, colloidal anhydrous magnesium stearate hypromellose triacetin polysorbate 80 titanium dioxide indigo carmine aluminium lake yellow iron oxide)., DROSPIRENONE

Primary endpoint: Cohort 1: Adolescents Mean absolute change in lumbar spine (L1-L4) Z-score from baseline to 12 months as measured by dual-energy X-ray absorptiometry (DXA) Cohort 2: Adults Mean percentage change in lumbar spine (L1-L4) BMD from baseline to 12 months as measured by DXA
Endpoint(s): Please refer to the Protocol for Cohort 1 & 2 (Section 7), Changes in body weight and body mass index (BMI), Mean absolute and relative changes in routine laboratory values from baseline to 6 months and to 12 months, Mean absolute and relative changes in serum estradiol (E2) levels in the hormonal treatment arm from baseline to 6 months and to 12 months, Adverse events

Source: https://euclinicaltrials.eu/ctis-public/view/2024-512347-23-00